EU clinical trial 2023-509109-57-01: Hip Infiltration in Hip Arthroplasty (HiHa) study – a randomized controlled trial
Protocol code: OC-2023-005
Sponsor: Reinier Haga Groep Orthopedisch Centrum B.V. (Hospital/Clinic/Other health care facility). Phase: Therapeutic use (Phase IV). Countries: Netherlands (authorised, recruitment pending).
Therapeutic area(s): Analytical, Diagnostic and Therapeutic Techniques and Equipment [E] - Anesthesia and Analgesia [E03]; Diseases [C] - Musculoskeletal Diseases [C05]
Gender: Female, Male. Age: 18-64 years, 65+ years. Enrolment: 120.
Status: Authorised, recruitment pending. Decision date: 2025-04-24. Results received: No. Last updated: 2026-07-27.

Condition(s): Total Hip Arthroplasty / THA
Product: ROPIVACAINE HYDROCHLORIDE, SODIUM CHLORIDE

Primary endpoint: Use of escape pain medication during the first 6 hours after the intra-articular injection of the hip
Endpoint(s): Percentage of patients that use escape pain medication on day 0 and during hospital stay until discharge, Pain measured with NRS, Side effects related to the use of pain medication, Amount of other escape medication used, Satisfaction measured with the Net Promotor Score (NPS), Perioperative blood loss, Need for blood tranfusion

Source: https://euclinicaltrials.eu/ctis-public/view/2023-509109-57-01